EU clinical trial 2024-514548-10-01: Double-blind, randomised clinical study comparing efficacy and safety of Methylprednisolone Aceponate 0.1% Ointment (Test) vs. Advantan® 0.1% Ointment (Reference) vs. Vehicle in patients with mild to moderate atopic dermatitis
Protocol code: 19-02/MPA-S
Sponsor: Dermapharm AG (Pharmaceutical company). Phase: Human Pharmacology (Phase I)- Other. Countries: Germany (ended).
Therapeutic area(s): Diseases [C] - Skin and Connective Tissue Diseases [C17]
Gender: Female, Male. Age: 0-17 years, 18-64 years, 65+ years. Enrolment: 330.
Status: Ended. Start date (EU): 2021-07-26. End date (EU): 2026-06-18. Decision date: 2024-08-13. Results received: No. Last updated: 2026-04-15.

Condition(s): Mild to moderate atopic dermatitis
Product: Vehicle to Methylprednisolone Aceponate Ointment, Methylprednisolone Aceponate Ointment, Advantan® 0,1% Salbe

Primary endpoint: The primary endpoint of the study is the percent change from baseline (Visit 1) to Visit 4 (EOT) assessed by Eczema Area and Severity Index (EASI)
Endpoint(s): Percent change of Eczema Area and Severity Index (EASI) between visits, Percent change of the total affected body surface area (BSA) between visits, and between baseline and week 3 (EOT), Change of the Investigator’s Global Assessment (IGA) between visits, and between baseline and week 3 (EOT), Evaluation of Overall Therapeutic Success by the investigator and patient at week 3 (EOT), Patient´s assessment of severity of pruritus

Source: https://euclinicaltrials.eu/ctis-public/view/2024-514548-10-01